EU clinical trial 2023-505863-35-00: A Phase 2, open-label, randomized trial evaluating the impact of enhanced versus standard dermatologic management on selected dermatologic adverse events among patients with locally advanced or metastatic EGFR-mutated NSCLC treated first-line with amivantamab + lazertinib
Protocol code: 61186372NSC2007
Sponsor: Janssen - Cilag International (Pharmaceutical company). Phase: Therapeutic exploratory (Phase II). Countries: Germany (ongoing, recruitment ended), France (ongoing, recruitment ended), Spain (ongoing, recruitment ended).
Therapeutic area(s): Diseases [C] - Neoplasms [C04]
Gender: Female, Male. Age: 18-64 years, 65+ years. Enrolment: 15.
Status: Ongoing, recruitment ended. Start date (EU): 2024-03-20. Decision date: 2024-03-18. Results received: No. Last updated: 2026-05-29.
Decision dates by country: ES: 2024-04-19, DE: 2024-03-20, FR: 2024-03-22

Condition(s): EGFR-mutated Advanced or Metastatic Non-small Cell Lung Cancer
Product: MINOCIN 50 mg capsule rigide, Zink Verla® 10 mg, Filmtabletten, Protopic 0.1% ointment, Timolol 0,5 % AT - 1 A Pharma, 5 mg/ml Augentropfen, Lösung, Doxy-M-ratiopharm® 100 mg Tabletten, Dalacin 10 mg emulsión cutánea, Timolol Micro Labs 5 mg/ml Augentropfen, Losung, Doxy-M-ratiopharm 100 mg tabletės, ClobeGalen 500 Mikrogramm/g Shampoo, Opzelura 15 mg/g cream, Protopic 0.1% ointment, Chlorhexidine, Doxyderma 50 mg, JNJ-61186372, JNJ-73841937, JNJ-61186372, Minocyclin-ratiopharm® 100 mg Hartkapseln, Dociton® 10 mg Filmtabletten

Primary endpoint: Incidence of Grade ≥2 DAEIs (Appendix 17: Dermatologic Adverse Events of Interest: Preferred Terms) in the first 12 weeks after initiation of amivantamab and lazertinib treatment

Source: https://euclinicaltrials.eu/ctis-public/view/2023-505863-35-00